EU clinical trial 2024-513022-29-00: A Randomized, Double-Blind, Placebo-Controlled, Parallel-Group, Multi-center Study to Compare the Anti-Depressive Efficacy and Safety of Samyr® IM versus Placebo IM as an Enhancer Adjunctive to Antidepressant Treatment in Major Depression Disorder Patients Who have not Experienced Sufficient Symptoms Improvement Despite Antidepressant Treatment
Protocol code: MYL-1603N-3002
Sponsor: Mylan Inc. (Pharmaceutical company). Phase: Therapeutic confirmatory (Phase III). Countries: Italy (ongoing, recruiting).
Therapeutic area(s): Psychiatry and Psychology [F] - Mental Disorders [F03]
Gender: Female, Male. Age: 18-64 years. Enrolment: 468.
Status: Ongoing, recruiting. Start date (EU): 2019-01-09. Decision date: 2024-10-07. Results received: No. Last updated: 2026-08-06.

Condition(s): Major Depression Disorders
Product: Samyr placebo (saline solution), SAMYR 400 mg/5ml polvere e solvente per soluzione iniettabile, Sodio Cloruro Fresenius Kabi Italia 0,9%, solvente per uso parenterale

Primary endpoint: Change from baseline in the MADRS score after 7 days of treatment (visit 13).
Endpoint(s): MADRS change from baseline at scheduled visits., HRDS-6 (Per-Bech) change from baseline at scheduled visits., Change in CGI and PGI from baseline at scheduled visits.

Source: https://euclinicaltrials.eu/ctis-public/view/2024-513022-29-00